EU clinical trial 2022-503092-28-00: A Phase 3, Open Label, Randomized Study to Compare the Efficacy and Safety of Odronextamab (REGN1979), an Anti-CD20 x Anti-CD3 Bispecific Antibody, in Combination with Lenalidomide Versus Rituximab in Combination with Lenalidomide in Relapsed/Refractory Participants with Follicular Lymphoma and Marginal Zone Lymphoma (OLYMPIA-5)
Protocol code: R1979-ONC-22102
Sponsor: Regeneron Pharmaceuticals Inc. (Pharmaceutical company). Phase: Therapeutic confirmatory (Phase III). Countries: Spain (ongoing, recruitment ended), Czechia (ongoing, recruitment ended), Poland (ongoing, recruitment ended), Austria (ongoing, recruitment ended), Germany (ongoing, recruitment ended), Belgium (ongoing, recruitment ended), France (ongoing, recruitment ended), Italy (ongoing, recruitment ended).
Therapeutic area(s): Diseases [C] - Hemic and Lymphatic Diseases [C15]
Gender: Female, Male. Age: 18-64 years, 65+ years. Enrolment: 234.
Status: Ongoing, recruitment ended. Start date (EU): 2024-01-08. Decision date: 2023-09-25. Results received: No. Last updated: 2026-07-20.
Decision dates by country: FR: 2023-09-26, CZ: 2023-09-26, IT: 2023-09-27, BE: 2023-09-25, PL: 2023-09-29, AT: 2023-09-29, DE: 2023-09-27, ES: 2023-09-25

Condition(s): Relapsed/Refractory Follicular Lymphoma, Relapsed/Refractory Marginal Zone Lymphoma (MZL)
Product: LENALIDOMIDE, Truxima 500 mg concentrate for solution for infusion, LENALIDOMIDE, Odronextamab, LENALIDOMIDE, Truxima 100 mg concentrate for solution for infusion, Odronextamab

Primary endpoint: Part 1: Incidence of dose limiting toxicities (DLTs) for odronextamab in combination with lenalidomide, Part 1: Incidence of treatment emergent adverse events (TEAEs) for odronextamab in combination with lenalidomide, Part 1: Severity of TEAEs for odronextamab in combination with lenalidomide, Part 2: Progression-free survival (PFS) as assessed by independent central review (ICR) in participants with R/R FL and participants with indolent lymphoma (FL and MZL)
Endpoint(s): Part 1 & 2: Odronextamab concentrations in serum, Part 1 & 2: Incidence of anti-drug antibodies (ADA) to odronextamab, Part 1 & 2: Magnitude of ADAs to odronextamab, Part 1 & 2: Best overall response (BOR) as assessed by investigator review, Part 1 & 2: Duration of response (DOR) as assessed by investigator review, Part 1 & 2: PFS as assessed by investigator review, Part 2: Complete response (CR) as assessed by ICR, Part 2: BOR as assessed by ICR, Part 2: Overall survival (OS), Part 2: Event free survival (EFS) as assessed by ICR, Part 2: EFS as assessed by local investigator review, Part 2: DOR as assessed by ICR, Part 2: Time to next anti-lymphoma treatment (TTNT), Part 2: Incidence of TEAEs for odronextamab in combination with lenalidomide versus R2, Part 2: Severity of TEAEs for odronextamab in combination with lenalidomide versus R2, Part 2: Overall change in patient reported outcomes (PROs) as measured by scores of European Organisation for Research and Treatment of Cancer Quality-of-Life Questionnaire (EORTC QLQC30), Part 2: Overall change in PROs as measured by scores of Functional Assessment of Cancer Therapy–Lymphoma Subscale (FACT-LymS), Part 2: Change from first assessment in Patient Global Impression on Severity (PGIS), Part 2: Change from first assessment in Patient Global Impression on Change (PGIC), Part 2: Overall change in PROs as measured by scores of EuroQoL 5 Dimensions 5 Levels (EQ-5D-5L), Part 2: Change from first assessment in the global population item 5 (GP5) items of the Functional Assessment of Cancer Therapy–General (FACT-G) questionnaire

Source: https://euclinicaltrials.eu/ctis-public/view/2022-503092-28-00